EU clinical trial 2023-507067-19-00: Open-Label Study to Assess the Safety, Efficacy, Pharmacokinetics, and Pharmacodynamics of Povetacicept in Subjects with Autoimmune Cytopenias (RUBY-4)
Protocol code: AIS-D04
Sponsor: Alpine Immune Sciences Inc. (Pharmaceutical company). Phase: Therapeutic exploratory (Phase II). Countries: Italy (ended), Spain (ended), Norway (ended), Austria (ended), Germany (ended).
Therapeutic area(s): Diseases [C] - Immune System Diseases [C20]; Diseases [C] - Hemic and Lymphatic Diseases [C15]
Gender: Female, Male. Age: 18-64 years, 65+ years. Enrolment: 34.
Status: Ended. Start date (EU): 2024-05-15. End date (EU): 2026-06-09. Decision date: 2024-04-15. Results received: No. Last updated: 2026-01-19.
Decision dates by country: DE: 2024-04-17, NO: 2024-05-17, AT: 2024-04-22, ES: 2024-04-15, IT: 2024-04-17

Condition(s): Autoimmune Cytopenias (warm autoimmune hemolytic anemia [wAIHA], cold agglutinin disease [CAD], immune thrombocytopenia [ITP])
Product: Povetacicept Injection

Primary endpoint: Type, incidence, severity, and seriousness of AEs.
Endpoint(s): Assessment of efficacy, PK, and ADA

Source: https://euclinicaltrials.eu/ctis-public/view/2023-507067-19-00